EU clinical trial 2023-503380-42-00: The USTAP CD trial USTekinumab in fistulising Perianal Crohn’s Disease: The USTAP CD study
Protocol code: GT-2019-01
Sponsor: Groupe D'etude Therapeutique Des Affections Inflammatoires Du Tube Digestif (Laboratory/Research/Testing facility). Phase: Therapeutic use (Phase IV). Countries: France (ongoing, recruitment ended).
Therapeutic area(s): Diseases [C] - Digestive System Diseases [C06]
Gender: Female, Male. Age: 18-64 years. Enrolment: 146.
Status: Ongoing, recruitment ended. Start date (EU): 2020-11-16. Decision date: 2024-08-28. Results received: No. Last updated: 2024-08-28.

Condition(s): patient with moderate to severe Crohn's disease with at least one active perianal fistula track

Source: https://euclinicaltrials.eu/ctis-public/view/2023-503380-42-00